EU clinical trial 2023-503620-60-00: A Multi-arm Phase 1b Study of Talquetamab With Other Anticancer Therapies in Participants with Multiple Myeloma
Protocol code: 64407564MMY1004
Sponsor: Janssen - Cilag International (Pharmaceutical company). Phase: Human Pharmacology (Phase I)- Other. Countries: Netherlands (ongoing, recruitment ended), France (ongoing, recruitment ended), Belgium (ended).
Therapeutic area(s): Diseases [C] - Neoplasms [C04]
Gender: Female, Male. Age: 18-64 years, 65+ years. Enrolment: 49.
Start date (EU): 2021-12-22. Decision date: 2024-05-08. Results received: No. Last updated: 2025-12-05.
Decision dates by country: BE: 2024-05-13, FR: 2024-05-14, NL: 2024-05-08

Condition(s): multiple myeloma

Source: https://euclinicaltrials.eu/ctis-public/view/2023-503620-60-00